EU clinical trial 2024-519269-23-00: Evaluation of the efficacy of topical treatment with budesonide in children with Crohn's disease located in the esophagus and/or stomach and/or duodenum - BETHESDa
Protocol code: BETHESDaCD
Sponsor: Medical University Of Warsaw (Educational Institution). Phase: Therapeutic confirmatory (Phase III). Countries: Poland (ended).
Therapeutic area(s): Diseases [C] - Digestive System Diseases [C06]
Gender: Female, Male. Age: 0-17 years. Enrolment: 138.
Status: Ended. Start date (EU): 2024-03-27. End date (EU): 2026-03-31. Decision date: 2024-12-20. Results received: No. Last updated: 2025-07-10.

Condition(s): Crohn's disease
Product: Ultop, 10 mg, kapsułki dojelitowe, twarde, BUDIXON NEB, 0,50 mg/ml, zawiesina do nebulizacji

Primary endpoint: Percentage of patients with no endoscopic and histopathological changes in the esophagus and/or stomach and/or duodenum
Endpoint(s): the proportion of patients with no evidence of endoscopic changes in the esophagus, stomach, duodenum, respectively (which were present at entry into the tests) - 8th week;, percentage of patients with no histopathological changes in the esophagus, stomach, duodenum, respectively (which were present at entry into the study) - 8th week;, disease activity assessed on the PCDAI scale (Pediatric Crohn Disease Activity Index) assessed in the 8th week;, the percentage of patients whose upper gastrointestinal symptoms disappeared - 4th, 8th, 12th week;, a percentage of patients with adverse effects of steroids - 4th, 8th, 12th week;, assessment of treatment tolerance on a 10-point VAS scale - 4th, 8th week.

Source: https://euclinicaltrials.eu/ctis-public/view/2024-519269-23-00